EU clinical trial 2023-509230-19-00: A first-in-human, Phase 1/2, open-label, multi-center, dose-escalation, dose-optimization, and dose-expansion study to evaluate the safety, tolerability, pharmacokinetics, pharmacodynamics, and antitumor activity of PARP1-selective inhibitor, EIK1003 (IMP1734), as monotherapy and in combination in participants with advanced solid tumors.
Protocol code: EIK1003-001
Sponsor: Eikon Therapeutics Inc. (Pharmaceutical company). Phase: Phase I and Phase II (Integrated)- First administration to humans. Countries: France (ongoing, recruiting), Spain (ongoing, recruiting), Denmark (ongoing, recruiting).
Therapeutic area(s): Diseases [C] - Neoplasms [C04]
Gender: Female, Male. Age: 18-64 years, 65+ years. Enrolment: 87.
Status: Ongoing, recruiting. Start date (EU): 2024-11-14. Decision date: 2024-07-24. Results received: No. Last updated: 2026-08-06.
Decision dates by country: FR: 2024-07-26, DK: 2024-07-25, ES: 2024-07-24

Condition(s): Advance solid tumors
Product: CARBOPLATIN, PREDNISONE, PACLITAXEL, ABIRATERONE, EIK1003 20mg Tablets, EIK1003 5mg Tablets

Primary endpoint: Part 1 and 2: • TEAEs • DLTs • Laboratory parameters • Vital signs • ECGs
Endpoint(s): PK parameters derived from plasma concentration data of EIK1003 and/or metabolites (if applicable) following single oral dose: • Cmax, Tmax, AUC0-t, AUC0-tau, Cmax(dn), and AUC0-tau(dn) • If data permit, AUC0-inf, CL/F, Vd/F, and t1/2, PK parameters derived from plasma concentration data of EIK1003 and/ormetabolites (if applicable) following multiple oral doses: • Cmax,ss, Ctrough, Tmax,ss, AUC0-t,ss, AUC0-tau,ss, Cmax,ss(dn), AUC0-tau(dn), Rac-Cmax,ss and Rac-AUC0-tau,ss, • If data permit, CL/F, Vd/F, and t1/2 Cohorts 1A, 1B, and 1C: • Overall response rate, which is defined as the percentage of participants who have CR/PR per RECIST v1.1, by Investigator and/or CA125 response per GCIG criteria (ovarian cancer), and/or PSA and/or bone scan response per PCWG3 criteria (prostate cancer)., • Efficacy evaluated per RECIST v1.1 by Investigator: o ORR o DCR o DOR o TTR o Percentage change in sum of target lesions o CBR, which is defined as the proportion of participants with BOR of CR, PR or lasting ≥ 18 weeks of SD after the start of the investigational medical product (IMP) • PFS • OS • For prostate cancer only: o PSA response per PCWG3 criteria o PSA progression o PSA complete response rate, • PFS • OS • For prostate cancer only: o PSA response per PCWG3 criteria o PSA progression o PSA complete response rate, Cohort 1D: • Overall response rate, which is defined as the percentage of participants who have CR/PR per RECIST v1.1 by Investigator, and/or CA125 response per GCIG criteria • Efficacy evaluated per RECIST v1.1 by Investigator: o ORR o DCR o TTR

Source: https://euclinicaltrials.eu/ctis-public/view/2023-509230-19-00